EU clinical trial 2024-518403-22-00: Prospective study to assess with Continuous Glucose Monitoring (CGM) the efficacy and safety of switching to insulin glargine 300 U/ml from insulin glargine 100 U/ml in Type 2 Diabetes (T2DM) patients with renal impairment
Protocol code: LPS17375
Sponsor: Sanofi Aventis S.A. (Pharmaceutical company). Phase: Therapeutic use (Phase IV). Countries: Spain (ended).
Therapeutic area(s): Diseases [C] - Nutritional and Metabolic Diseases [C18]
Gender: Female, Male. Age: 18-64 years. Enrolment: 100.
Status: Ended. Start date (EU): 2022-06-20. End date (EU): 2025-07-09. Decision date: 2025-01-13. Results received: No. Last updated: 2025-01-13.

Condition(s): Diabetes mellitus II
Product: INSULIN GLARGINE

Primary endpoint: Change from baseline to Month 5 in the percentage of Time in Range (TIR)
Endpoint(s): Mean glucose profile over 24 hours, % Coefficient of variation, % Time below target glucose Range (TBR), % Time above target glucose Range (TAR), Change from baseline to Month 5 in HbA1c, Change from baseline to Month 5 in Fasting Plasma Glucose (FPG), Number of participants with at least one hypoglycemia event, Change from baseline to Month 5 in DTSQc, Number of participants with adverse events

Source: https://euclinicaltrials.eu/ctis-public/view/2024-518403-22-00